EU clinical trial 2023-509606-30-00: A randomised, double-blind, double-dummy, multicentre, phase III, non inferiority trial of an oral mesalazine formulation in patients with active mild to moderate ulcerative colitis for the induction of remission.
Protocol code: CGRA-0121/ES
Sponsor: Faes Farma S.A. (Pharmaceutical company). Phase: Therapeutic confirmatory (Phase III). Countries: Spain (ongoing, recruitment ended), Slovakia (ended), France (ended), Hungary (ongoing, recruitment ended), Bulgaria (ended), Czechia (ongoing, recruitment ended), Poland (ongoing, recruitment ended).
Therapeutic area(s): Diseases [C] - Digestive System Diseases [C06]
Gender: Female, Male. Age: 18-64 years, 65+ years. Enrolment: 408.
Start date (EU): 2024-07-24. Decision date: 2024-07-24. Results received: No. Last updated: 2026-07-10.
Decision dates by country: FR: 2024-07-26, CZ: 2024-07-26, HU: 2024-07-25, BG: 2024-08-22, PL: 2024-07-29, ES: 2024-07-24, SK: 2024-07-25

Condition(s): Ulcerative colitis
Product: Claversal 1 g comprimidos gastrorresistentes, Placebo 5-ASA comparator, Mesalazine, Placebo 5-ASA test

Primary endpoint: Percentage of patients with clinical remission defined by MMS ≤ 2 with symptomatic remission (stool frequency ≤ 1, rectal bleeding = 0) and endoscopic remission (MES ≤ 1) after 8 weeks of treatment.
Endpoint(s): [Secondary efficacy:] Percentage of patients achieving symptomatic remission (defined as stool frequency ≤ 1 and rectal bleeding = 0), after the 8-week treatment period, [Secondary efficacy:] Percentage of patients achieving endoscopic remission (defined as a MES ≤ 1), after the 8-week treatment period., [Secondary efficacy:] Percentage of patients achieving overall response (defined as a reduction in MMS ≥ 3 and ≥ 30% from baseline, with a decrease of rectal bleeding subscore ≥ 1 or absolute rectal bleeding subscore ≤ 1), after the 8 week treatment period., [Secondary efficacy:] Change in the symptomatic assessments of the MMS (stool frequency and rectal bleeding), from baseline to Week 8., [Secondary efficacy:] Change in the MES, from baseline to Week 8., [Secondary efficacy:] Percentage of patients achieving histological remission (defined by RHI ≤ 3 with subscores = 0 for lamina propria neutrophils and neutrophils in epithelium) at Week 8., [Secondary efficacy:] Percentage of patients achieving overall remission (all modified Mayo subscores = 0) at Week 8., [Secondary efficacy:] Percentage of patients achieving clinical remission and histologic remission at Week 8., [Secondary efficacy:] Change in Short Inflammatory Bowel Disease Questionnaire (SIBDQ), from baseline to Week 8., [Secondary efficacy:] Change in faecal calprotectin values, from baseline (V2) to Week 8., [Secondary safety and tolerability:] Monitoring adverse events: - Incidence of adverse events (related/unrelated). - Incidence of adverse events by maximum severity (related/unrelated). - Incidence of serious adverse events (related/unrelated). - Incidence of adverse events leading to discontinuation of trial drug. - Incidence of adverse events resulting in death., [Secondary safety and tolerability:] Biochemistry, haematology, and urinalysis: - Number of patients with clinically significant results at Week 8 in haematological parameters. - Number of patients with clinically significant results at Week 8 in biochemical parameters. - Number of patients with clinically significant results at Week 8 in urinalysis parameters., [Secondary safety and tolerability:] Physical examination and vital signs - Number of patients with clinically significant findings in physical examination from baseline (V2) to Week 8. - Changes in vital signs parameters from baseline (V2) to Week 8., [Secondary safety and tolerability:] Preference of the pharmaceutical formulation of the IMP evaluated through the Treatment Satisfaction and Acceptability Questionnaire.

Source: https://euclinicaltrials.eu/ctis-public/view/2023-509606-30-00